EU clinical trial 2024-519919-34-00: A Phase 3, Randomized, Double-Blind, Placebo-Controlled Study of the Efficacy and Safety of Daily Piclidenoson (CF101) Administered Orally in Subjects with Moderate-to-Severe Plaque Psoriasis
Protocol code: CF101-302PS
Sponsor: Can-Fite Biopharma Ltd. (Pharmaceutical company). Phase: Therapeutic confirmatory (Phase III). Countries: Poland (ongoing, recruitment ended), Greece (ongoing, recruitment ended), Bulgaria (ongoing, recruitment ended).
Therapeutic area(s): Diseases [C] - Skin and Connective Tissue Diseases [C17]; Diseases [C] - Immune System Diseases [C20]
Gender: Female, Male. Age: 18-64 years, 65+ years. Enrolment: 366.
Status: Ongoing, recruitment ended. Start date (EU): 2025-08-18. Decision date: 2025-06-16. Results received: No. Last updated: 2026-06-26.
Decision dates by country: GR: 2025-06-16, PL: 2025-11-15, BG: 2025-06-27

Condition(s): Plaque psoriasis
Product: Piclidenoson, Matching Placebo for Piclidenoson

Primary endpoint: Proportion of subjects achieving PASI 75, Proportion of subjects achieving sPGA of 0 or 1 with at least a 2- point improvement from Baseline, Proportion of subjects achieving PASI 50, PASI 90, or PASI 100, Proportion of subjects achieving both PASI 75 and sPGA of 0 or 1 with at least a 2-point improvement from Baseline, Change from Baseline and Percent Change from Baseline in PASI score, Proportion of subjects achieving PSSD of 0 or 1, Proportion of subjects achieving DLQI of 0 or 1, Change from Baseline in percentage of BSA involved, Change from Baseline in PSSD, Change from Baseline in DLQI, For Segment 2 only: Percentage Change from Baseline in PSSI, For Segment 2 only: Percentage Change from Baseline in NAPSI, For Segment 2 only: Time to psoriasis relapse during the placebo-controlled withdrawal period, For Segment 2 only: Proportion of subjects who experience a psoriasis relapse during the placebo-controlled withdrawal period, For Segment 2 only: Proportion of subjects who experience a psoriasis relapse and subsequently achieve PASI 75 during retreatment with piclidenoson
Endpoint(s): Proportion of subjects who achieve both PASI 75 and sPGA of 0 or 1 with at least a 2-point improvement from Baseline at Week 16, Proportion of subjects who achieve improvement of the PSSD to a score of 0 or 1 at Week 16, Proportion of subjects who achieve improvement of the DLQI to a score of 0 or 1 at Week 16

Source: https://euclinicaltrials.eu/ctis-public/view/2024-519919-34-00